EU clinical trial 2025-523547-35-00: A Phase 1/2a, Open-label, Multicenter Study to Assess the Safety, Tolerability, Pharmacokinetics, Pharmacodynamics and Preliminary Efficacy of BMS-986523 as Monotherapy and in Combination with Anti-cancer Agents in Participants with Advanced Solid Malignancies
Protocol code: CA2560001
Sponsor: Bristol-Myers Squibb Services Unlimited Company (Pharmaceutical company). Phase: Phase I and Phase II (Integrated)- First administration to humans. Countries: Spain (authorised, recruitment pending).
Therapeutic area(s): Diseases [C] - Neoplasms [C04]
Gender: Female, Male. Age: 18-64 years, 65+ years. Enrolment: 16.
Status: Authorised, recruitment pending. Decision date: 2026-04-09. Results received: No. Last updated: 2026-04-29.
Decision dates by country: ES: 2026-04-29

Condition(s): Advanced Solid Tumor Malignancies
Product: BMS-986523, BMS-986523

Primary endpoint: How often side effects occur, including serious ones, side effects that meet study rules for a dose-limiting toxicity, and side effects that make people stop study treatment or cause death.
Endpoint(s): Overall response rate to BMS-986523 and how long that response lasts based on RECIST v1.1 as judged by the study doctor., How BMS-986523 moves through and is processed by the body, including the highest level of the drug in the blood (Cmax), how long it takes to reach that level (Tmax), and overall exposure (AUC), based on blood tests over time.

Source: https://euclinicaltrials.eu/ctis-public/view/2025-523547-35-00